EU clinical trial 2025-523391-22-01: The Role of Beta-Blockade During Cardiac CT in Patients with Atrial Fibrillation
Sponsor: Semmelweis University (Educational Institution). Phase: Therapeutic use (Phase IV). Countries: Hungary (ongoing, recruiting).
Therapeutic area(s): Diseases [C] - Cardiovascular Diseases [C14]
Gender: Female, Male. Age: 18-64 years, 65+ years. Enrolment: 136.
Status: Ongoing, recruiting. Start date (EU): 2026-01-20. Decision date: 2025-10-22. Results received: No. Last updated: 2025-10-22.

Condition(s): Atrial fibrillation, Coronary artery disease

Source: https://euclinicaltrials.eu/ctis-public/view/2025-523391-22-01